EU clinical trial 2023-508977-10-00: NEurotrophins MImetic compound for modulation of ischemia/reperfusion damage in Liver transplantation with Extended criteria Donors, a phase I/II explorative, open label, controlled, randomized study
Protocol code: NEMILED
Sponsor: Mimetech S.r.l. (Industry). Phase: Phase I and Phase II (Integrated)- Other. Countries: Italy (authorised, recruitment pending).
Therapeutic area(s): Diseases [C] - Pathological Conditions, Signs and Symptoms [C23]; Diseases [C] - Nutritional and Metabolic Diseases [C18]; Diseases [C] - Digestive System Diseases [C06]; Analytical, Diagnostic and Therapeutic Techniques and Equipment [E] - Therapeutics [E02]
Gender: Female, Male. Age: 18-64 years, 65+ years. Enrolment: 24.
Status: Authorised, recruitment pending. Decision date: 2024-03-13. Results received: No. Last updated: 2026-06-04.

Condition(s): Liver Transplant

Source: https://euclinicaltrials.eu/ctis-public/view/2023-508977-10-00